EU clinical trial 2023-510098-33-01: A Phase III, Multicentre, Randomised, Open-label Study to Compare the Efficacy and Safety of AZD0486 plus Rituximab versus Chemotherapy plus Rituximab in Previously Untreated Participants with Follicular Lymphoma (SOUNDTRACK-F1)
Protocol code: D7401C00001
Sponsor: AstraZeneca AB (Pharmaceutical company). Phase: Therapeutic confirmatory (Phase III). Countries: Denmark (authorised, recruitment pending).
Therapeutic area(s): Diseases [C] - Neoplasms [C04]
Gender: Female, Male. Age: 18-64 years, 65+ years. Enrolment: 15.
Status: Authorised, recruitment pending. Decision date: 2026-07-29. Results received: No. Last updated: 2026-07-29.

Condition(s): Follicular Lymphoma
Product: RITUXIMAB, RITUXIMAB, VINCRISTINE, DOXORUBICIN, PREDNISONE, AZD0486, BENDAMUSTINE, CYCLOPHOSPHAMIDE

Primary endpoint: 1.SRI primary: Safety evaluation of Surovatamig in combination with Rituximab, 2.SRI Primary: Determination of the recommended Phase III dose (RP3D), 3.Phase 3 Primary: To demonstrate the superiority of clinical efficacy of Surovatamig+R compared to SOC chemoimmunotherapy in participants with untreated FL
Endpoint(s): Safety Run in and Phase 3: ORR, Safety Run In and Phase 3: CR Rate, Safety Run In and Phase 3: CR at EoI, Safety Run In and Phase 3: DoR, Safety Run In and Phase 3: PFS, Safety Run In and Phase 3: OS, Phase 3: CR rate at 30 months, Phase 3: TFST, Phase 3: PFS2

Source: https://euclinicaltrials.eu/ctis-public/view/2023-510098-33-01